EU clinical trial 2024-515988-55-00: A PHASE 1/2, DOSE AND SCHEDULE EVALUATION STUDY TO INVESTIGATE THE SAFETY AND CLINICAL ACTIVITY OF BELANTAMAB MAFODOTIN ADMINISTERED IN COMBINATION WITH LENALIDOMIDE AND DEXAMETHASONE IN PATIENTS WITH NEWLY DIAGNOSED MULTIPLE MYELOMA TRANSPLANT INELIGIBLE
Protocol code: EAE-2020/MM0107
Sponsor: Hellenic Society Of Hematology (Patient organisation/association). Phase: Therapeutic exploratory (Phase II). Countries: Greece (ongoing, recruitment ended).
Therapeutic area(s): Diseases [C] - Neoplasms [C04]
Gender: Female, Male. Age: 18-64 years, 65+ years. Enrolment: 66.
Status: Ongoing, recruitment ended. Start date (EU): 2021-02-22. Decision date: 2024-11-27. Results received: No. Last updated: 2025-10-21.

Condition(s): Newly diagnosed multiple myeloma
Product: DEXAMETHASONE, LENALIDOMIDE, LENALIDOMIDE, LENALIDOMIDE, DEXAMETHASONE, LENALIDOMIDE, LENALIDOMIDE

Primary endpoint: Part 1 Number of participants with dose-limiting toxicities (DLTs). Number of participants with adverse events (AEs) and serious adverse events (SAEs). Part 2 Overall Response rate as per International Myeloma Working Group (IMWG) by Investigator Assessment. Number of participants with adverse events (AEs) and serious adverse events (SAEs).
Endpoint(s): Lenalidomide relative Dose Intensity (RDI)., Cumulative administered dose of belantamab mafodotin in combination with lenalidomide and dexamethasone (Rd), Time to Response (TTR) as per IMWG by Investigator Assessment., Duration of Response (DoR) as per IMWG by Investigator Assessment., Complete Response Rate (CRR) as per IMWG by Investigator Assessment., MRD negativity rate in the bone marrow (BM), defined as the number (%) of participants who achieve MRD negativity (at or below the threshold of 10-5), assessed via NGF. MRD will be assessed via nextgeneration flow (NGF) cytometry., Progression Free Survival (PFS) as per IMWG by Investigator Assessment, Overall Survival (OS)., Number of participants with abnormal ocular findings (on ophthalmic exam)., Derived PK parameter values for belantamab mafodotin ADC., Number of participants with changes from baseline and proportion of participants with within-participant meaningful change in self reported ocular symptoms and related impacts as measured by the OSDI questionnaire (Part 1only)., Number of participants with changes from baseline and proportion of participants with within-participant meaningful change in ocular symptoms and related impacts as measured by the Vision Related Anamnestic Tool (Part 2 only)

Source: https://euclinicaltrials.eu/ctis-public/view/2024-515988-55-00